EU clinical trial 2024-517761-17-00: Daratumumab for first line treatment of transplant-ineligible myeloma patients followed by daratumumab re-treatment at first relapse (GMMG-DADA)
Protocol code: UNI-KOELN-3946
Sponsor: University Of Cologne (Educational Institution). Phase: Therapeutic exploratory (Phase II). Countries: Germany (ongoing, recruitment ended).
Therapeutic area(s): Diseases [C] - Hemic and Lymphatic Diseases [C15]
Gender: Female, Male. Age: 18-64 years, 65+ years. Enrolment: 67.
Status: Ongoing, recruitment ended. Start date (EU): 2021-05-31. Decision date: 2024-10-24. Results received: No. Last updated: 2026-04-15.

Condition(s): Multiple Myeloma
Product: DARZALEX 1800 mg solution for injection

Primary endpoint: Response (≥VGPR) after 8 cycles of DVCd
Endpoint(s): Minimal residual disease (MRD) negativity at any time before and during maintenance therapy (DVd) assessed by NGS at a level of 10e-5, Progression-free survival at 12 months from start of second line therapy, Progression-free survival from trial inclusion (PFS), Time to next treatment (TTNT), Overall survival (OS), Overall response rate of first line treatment, Overall response rate of second line treatment, Minimal residual disease (MRD) negativity at any time before and during maintenance therapy (DVd) assessed by NGS at other thresholds or by Flow

Source: https://euclinicaltrials.eu/ctis-public/view/2024-517761-17-00